EU clinical trial 2024-513559-34-00: A Randomized, Multicenter, Open-label, Phase III Study of Lurbinectedin Single-Agent or Lurbinectedin in Combination with Irinotecan versus Investigator’s Choice (Topotecan or Irinotecan) in Relapsed Small Cell Lung Cancer (SCLC) Patients (LAGOON Trial)
Protocol code: PM1183-C-008-21
Sponsor: Pharma Mar S.A. (Pharmaceutical company). Phase: Therapeutic confirmatory (Phase III). Countries: Poland (ended), France (ended), Germany (ended), Austria (ended), Denmark (ended), Italy (ended), Bulgaria (ended), Spain (ended), Belgium (ended), Romania (ended), Hungary (ended).
Therapeutic area(s): Diseases [C] - Neoplasms [C04]
Gender: Female, Male. Age: 18-64 years, 65+ years. Enrolment: 517.
Status: Ended. Start date (EU): 2022-07-19. End date (EU): 2026-04-10. End date: 2026-04-11. Decision date: 2024-07-05. Results received: No. Last updated: 2026-02-23.
Decision dates by country: DK: 2024-07-05, PL: 2024-07-09, AT: 2024-07-09, FR: 2024-07-05, RO: 2024-07-22, DE: 2024-07-09, BE: 2024-07-05, BG: 2024-07-08, HU: 2024-07-05, ES: 2024-07-05, IT: 2024-08-12

Condition(s): Small Cell Lung Cancer (SCLC)
Product: TOPOTECAN, TOPOTECAN, IRINOTECAN, TOPOTECAN, lurbinectedin, TOPOTECAN

Primary endpoint: Overall survival (OS)
Endpoint(s): Progression-free survival (PFS) by Independent Review Committee (IRC)/Investigator's Assessment (IA), Overall response rate (ORR) by IRC/IA, OS rate at 12 and 24 months and PFS rate at 6 and 12 months by IRC/IA, Duration of response (DoR) by IRC/IA, Treatment safety profile, Patient-reported outcomes (PRO), Subgroup analyses: Subgroup analyses of efficacy and safety, Plasma pharmacokinetics (PK) of lurbinectedin, irinotecan and its metabolite SN-38, PK/PD correlation, Pharmacogenomics (PGx)

Source: https://euclinicaltrials.eu/ctis-public/view/2024-513559-34-00